EU clinical trial 2022-501466-21-00: J2O-MC-EKBC: KRAKEN: A Phase 2, Randomized, Double-Blind, Placebo-Controlled Study to Investigate the Efficacy and Safety of Oral Once-Daily LY3473329 in Adults with Elevated Lipoprotein(a) at High Risk for Cardiovascular Events
Protocol code: J2O-MC-EKBC
Sponsor: Eli Lilly & Co. (Pharmaceutical company). Phase: Therapeutic exploratory (Phase II). Countries: Hungary (ended), Netherlands (ended), Germany (ended).
Therapeutic area(s): Diseases [C] - Cardiovascular Diseases [C14]
Gender: Female, Male. Age: 18-64 years, 65+ years. Enrolment: 100.
Status: Ended. Start date (EU): 2023-03-01. End date (EU): 2024-03-12. End date: 2024-03-14. Decision date: 2023-02-09. Results received: Yes. Last updated: 2023-05-24.
Decision dates by country: NL: 2023-02-09, DE: 2023-02-10, HU: 2023-02-10

Condition(s): Lipoprotein Disorder
Product: Placebo to match LY3473329

Primary endpoint: Percent Change from Baseline in Lipoprotein (a) Lp(a) [Time Frame: Baseline to Week 12]

Source: https://euclinicaltrials.eu/ctis-public/view/2022-501466-21-00